EU clinical trial 2025-520792-67-00: A phase III trial of a De-escalated Immune-strategy During first-line treAtment in patients with metastatic non-small Cell lung cancer (NSCLC): DIDaC
Protocol code: DIDaC/ NVALT35
Sponsor: Leids Universitair Medisch Centrum (LUMC) (Hospital/Clinic/Other health care facility). Phase: Therapeutic confirmatory (Phase III). Countries: Netherlands (authorised, recruitment pending).
Therapeutic area(s): Diseases [C] - Neoplasms [C04]
Gender: Female, Male. Age: 18-64 years, 65+ years. Enrolment: 500.
Status: Authorised, recruitment pending. Decision date: 2025-09-12. Results received: No. Last updated: 2025-09-12.

Condition(s): Patients with advanced, metastatic NSCLC that have not progressed on a standard of care immunotherapy regimen 6 months after initiation of first line treatment.
Product: KEYTRUDA 25 mg/mL concentrate for solution for infusion, ALIMTA 500 mg powder for concentrate for solution for infusion

Primary endpoint: Time to disease progression as measured by RECIST 1.1 or death due to any cause in each arm, where each patient is followed for progression for a maximum of 18 months after randomization.
Endpoint(s): Number of patients alive at 18 months after randomization of the last patient in each arm., The number and type of adverse events classified by CTCAE 5.0 grading in each arm., EQ-5D-5L, QLQ-C30 and QLQ-LC19 questionnaire measured in each arm at baseline and every 3 months thereafter until progression with a maximum of 18 months after randomisation., iMC, EQ-5D-5L questionnaire measured in each arm at baseline and every 3 months thereafter until progression with a maximum of 18 months after randomisation.

Source: https://euclinicaltrials.eu/ctis-public/view/2025-520792-67-00